EU clinical trial 2024-510768-21-00: SGM-LARRC: Multicenter, open-label, controlled, parallel arms clinical study on the performance of SGM-101, a fluorochrome-labeled anti-carcino-embryonic antigen (CEA) monoclonal antibody, for locally advanced or recurrent rectal cancerpatients undergoing curative surgery.
Protocol code: NL69838.056.19
Sponsor: Academisch Ziekenhuis Leiden (Hospital/Clinic/Other health care facility). Phase: Therapeutic exploratory (Phase II). Countries: Netherlands (ongoing, recruiting).
Therapeutic area(s): Diseases [C] - Digestive System Diseases [C06]; Diseases [C] - Neoplasms [C04]
Gender: Female, Male. Age: 18-64 years, 65+ years. Enrolment: 203.
Status: Ongoing, recruiting. Start date (EU): 2019-10-16. Decision date: 2024-10-01. Results received: No. Last updated: 2024-10-01.

Condition(s): Rectal cancer
Product: SGM-101

Primary endpoint: The primary endpoint is the rate of patients with R0 resections. This endpoint is based on the primary objective of clinical benefit of FGOS combined with SGM-101 as the intraoperative imaging agent.
Endpoint(s): Concordance between intraoperative fluorescence assessment of resected lesions and their histopathology., For every removed specimen: rate of false negatives, false positives, true negatives and true positives concerning fluorescence, with histopathology as the gold standard., Tumor to background ratio (TBR) for fluorescence in malignant and benign tissue., Modification of operative plan due to imaging (e.g. more/less extensive resection or adjustment of IORT) and change in postoperative treatment will be recorded., 30-day mortality and 30-day complication rates., 2-year overall survival, 2-year disease free survival and 2-year local recurrence free survival.

Source: https://euclinicaltrials.eu/ctis-public/view/2024-510768-21-00